EU clinical trial 2023-507611-35-00: A Phase 1 Study to Investigate the Safety and Tolerability of the Study Drug GB-0895 in Mild to Moderate Asthma Patients or Single Dose in Chronic Obstructive Pulmonary Disease (COPD)
Protocol code: GB-0895-101
Sponsor: Generate Biomedicines Inc. (Pharmaceutical company). Phase: Human Pharmacology (Phase I)- First administration to humans. Countries: Germany (ongoing, recruiting).
Therapeutic area(s): Diseases [C] - Respiratory Tract Diseases [C08]
Gender: Female, Male. Age: 18-64 years. Enrolment: 70.
Status: Ongoing, recruiting. Start date (EU): 2024-03-01. Decision date: 2024-02-09. Results received: No. Last updated: 2026-02-25.
Decision dates by country: DE: 2024-02-16

Condition(s): mild to moderate asthma, Chronic Obstructive Pulmonary Disease (COPD)

Source: https://euclinicaltrials.eu/ctis-public/view/2023-507611-35-00